EU clinical trial 2024-516313-20-00: Nivolumab and ipilimumab in patients with dMMR and/or MSI metastatic colorectal cancer resistant to anti-PD1 monotherapy: An open-label phase II GERCOR trial (NIPIRESCUE)
Protocol code: NIPIRESCUE_G-113
Sponsor: Association Gercor (Laboratory/Research/Testing facility). Phase: Therapeutic exploratory (Phase II). Countries: France (ongoing, recruitment ended).
Therapeutic area(s): Diseases [C] - Neoplasms [C04]
Gender: Female, Male. Age: 18-64 years, 65+ years. Enrolment: 30.
Status: Ongoing, recruitment ended. Start date (EU): 2022-04-19. Decision date: 2024-10-07. Results received: No. Last updated: 2026-03-13.

Condition(s): Metastatic colorectal cancer

Source: https://euclinicaltrials.eu/ctis-public/view/2024-516313-20-00